EU clinical trial 2023-509235-39-00: Cytisine in prolonged dosage versus Nicotine Replacement Therapy in nicotine-dependent patients with Chronic Kidney Disease - single-center, randomized, non-inferiority clinical trial.
Protocol code: SCARP
Sponsor: Narodowy Instytut Onkologii Im. Marii Sklodowskiej-Curie Panstwowy Instytut Badawczy (Hospital/Clinic/Other health care facility). Phase: Therapeutic use (Phase IV). Countries: Poland (ongoing, recruiting).
Therapeutic area(s): Diseases [C] - Disorders of Environmental Origin [C21]
Gender: Female, Male. Age: 18-64 years. Enrolment: 292.
Status: Ongoing, recruiting. Start date (EU): 2025-10-30. Decision date: 2024-03-20. Results received: No. Last updated: 2024-07-29.

Condition(s): Nicotine dependence, Chronic Kidney Disease
Product: Nicorette Invisipatch, 15 mg/ 16 h system transdermalny, plaster, Desmoxan, 1,5 mg, tabletki, Nicorette Fruit, 2 mg, tabletki do ssania, Nicorette Invisipatch, 25 mg/ 16 h system transdermalny, plaster, Nicorette Coolmint, 2 mg, tabletki do ssania, Nicorette Invisipatch, 10 mg/ 16 h system transdermalny, plaster

Primary endpoint: 6 months of abstinence from tobacco products defined as smoking no more than 5 cigarettes in the period from Designated Day Zero (subject to the grace period).
Endpoint(s): Abstinence after 3 months from Designated Day Zero (subject to the grace period) defined as abstinence at the end of treatment., Assessment and comparison of the severity of withdrawal symptoms in the study arm and control group in 7±2, 14±2 and 30±5 days after the start of treatment., Assessment and comparison of the occurrence and severity of adverse events in the study arm and control group after 7±2, 14±2, 30±5 and 84-90 days after the start of treatment.

Source: https://euclinicaltrials.eu/ctis-public/view/2023-509235-39-00